EU clinical trial 2024-516320-33-00: Intravesical instillation therapy with bacillus Calmette-Guérin (BCG) and sequential BCG and electromotive mitomycin-C (EMDA-MMC) in patients with high-risk non-muscle-invasive bladder carcinoma (FINNBLADDER 10)
Sponsor: Turku University Hospital (Hospital/Clinic/Other health care facility). Phase: Therapeutic confirmatory (Phase III). Countries: Finland (ongoing, recruiting).
Therapeutic area(s): Diseases [C] - Female Urogenital Diseases and Pregnancy Complications [C13]; Diseases [C] - Male Urogenital Diseases [C12]
Gender: Female, Male. Age: 18-64 years, 65+ years. Enrolment: 300.
Status: Ongoing, recruiting. Start date (EU): 2019-01-07. Decision date: 2024-09-19. Results received: No. Last updated: 2024-09-19.

Condition(s): Bladder cancer
Product: BCG-medac, jauhe ja liuotin suspensiota varten, virtsarakkoon, Mitomycin medac, 40 mg, jauhe ja liuotin liuosta varten, virtsarakkoon

Primary endpoint: Recurrence: defined as occurrence of histologically confirmed urothelial cancer recurrence of any stage or grade. Time for recurrence will be calculated from randomization date to date of biopsy/TUR-BT confirming recurrence.
Endpoint(s): Progression: defined as occurrence of biopsy/TUR-BT confirmed urothelial cancer with higher T-category as follows: Time for progression is calculated from randomization to the date of biopsy/TUR-BT/radiological evidence of metastasis confirming progression

Source: https://euclinicaltrials.eu/ctis-public/view/2024-516320-33-00